EU clinical trial 2024-518141-13-00: A pilot open label phase I trial to evaluate the safety and the tolerability of a combination of two HIV-1 inducers in HIV+ sub-type B patients under cART with undetectable viral load
Protocol code: ANRS 171 SYNACTHIV
Sponsor: ANRS Maladies Infectieuses Emergentes (Laboratory/Research/Testing facility). Phase: Human Pharmacology (Phase I)- Other. Countries: Belgium (ongoing, recruitment ended).
Therapeutic area(s): Diseases [C] - Virus Diseases [C02]
Gender: Male. Age: 18-64 years, 65+ years. Enrolment: 15.
Status: Ongoing, recruitment ended. Start date (EU): 2022-12-05. Decision date: 2024-10-16. Results received: No. Last updated: 2026-02-16.

Condition(s): HIV

Source: https://euclinicaltrials.eu/ctis-public/view/2024-518141-13-00